EU clinical trial 2024-519219-32-00: A Multi-Center, Double-Blind, Randomized, Placebo-Controlled Trial to Assess Efficacy and Safety of Omecamtiv Mecarbil in Patients with Symptomatic Heart Failure with Severely Reduced Ejection Fraction
Protocol code: CY 1033
Sponsor: Cytokinetics Inc. (Pharmaceutical company). Phase: Therapeutic confirmatory (Phase III). Countries: Spain (ongoing, recruiting), France (ongoing, recruiting), Poland (ongoing, recruiting), Germany (ongoing, recruiting), Greece (ongoing, recruiting), Italy (ongoing, recruiting).
Therapeutic area(s): Diseases [C] - Cardiovascular Diseases [C14]
Gender: Female, Male. Age: 18-64 years, 65+ years. Enrolment: 810.
Status: Ongoing, recruiting. Start date (EU): 2025-06-23. Decision date: 2025-06-03. Results received: No. Last updated: 2026-07-10.
Decision dates by country: GR: 2025-06-04, PL: 2025-06-16, DE: 2025-07-11, FR: 2025-07-15, ES: 2025-06-03, IT: 2025-07-29

Condition(s): Heart Failure With Reduced Ejection Fraction
Product: Omecamtiv Mecarbil, Matching Placebo, Omecamtiv Mecarbil, Omecamtiv Mecarbil

Primary endpoint: Time to the first event of the following components: • CV death • HF event
Endpoint(s): 1. Time to first HF event, CV death, LVAD implantation/cardiac transplantation or stroke, 2. Time to the first HF hospitalization, 3. Time to the first HF event, CV death, LVAD implantation/cardiac transplant, or stroke in a subgroup of patients with severe heart failure (LVEF < 30%, NYHA class 3-4, HF event within the last 3 months), 4. Time to the first event of the following components: CV death, LVAD implantation/cardiac transplantation, and strok, 5. Time to CV death, 6. Time to first event of stroke, 7. Time to all-cause death

Source: https://euclinicaltrials.eu/ctis-public/view/2024-519219-32-00